EU clinical trial 2024-515679-36-01: CAT-VHL - Exploring the role of Carbonic Anhydrase IX as diagnostic and Theranostic target in Von-Hippel Lindau disease
Protocol code: CAT-VHL
Sponsor: Ospedale San Raffaele S.r.l. (Hospital/Clinic/Other health care facility). Phase: Therapeutic exploratory (Phase II). Countries: Italy (authorised, recruitment pending).
Therapeutic area(s): Analytical, Diagnostic and Therapeutic Techniques and Equipment [E] - Therapeutics [E02]; Analytical, Diagnostic and Therapeutic Techniques and Equipment [E] - Diagnosis [E01]
Gender: Female, Male. Age: 18-64 years, 65+ years. Enrolment: 38.
Status: Authorised, recruitment pending. Decision date: 2025-10-24. Results received: No. Last updated: 2026-07-23.

Condition(s): Von-Hippel Lindau (VHL) Disease
Product: Zr-DFO-girentuximab

Primary endpoint: To evaluate the efficacy of CAIX-PET for the detection of tumors in patients with VHL disease.
Endpoint(s): To evaluate the diagnostic accuracy of CAIX-PET in VHL -/- tumors diagnosed in the sporadic setting., To evaluate the diagnostic accuracy of CAIX-PET in VHL disease., To evaluate the safety of CAIX-PET.

Source: https://euclinicaltrials.eu/ctis-public/view/2024-515679-36-01